EU clinical trial 2022-503105-38-00: SAMETA A Phase III, Open Label, Randomised, 3-Arm, Multi-Centre Study of Savolitinib plus Durvalumab versus Sunitinib and Durvalumab Monotherapy in Participants with MET-Driven, Unresectable and Locally Advanced or Metastatic Papillary Renal Cell Carcinoma (PRCC) (SAMETA)
Protocol code: D5086C00001
Sponsor: AstraZeneca AB (Pharmaceutical company). Phase: Therapeutic confirmatory (Phase III). Countries: France (ended), Poland (ongoing, recruitment ended), Italy (ongoing, recruitment ended), Netherlands (ongoing, recruitment ended), Romania (ended), Czechia (ended), Germany (ongoing, recruitment ended), Spain (ongoing, recruitment ended).
Therapeutic area(s): Diseases [C] - Neoplasms [C04]
Gender: Female, Male. Age: 18-64 years, 65+ years. Enrolment: 62.
Start date (EU): 2021-10-22. Decision date: 2024-06-18. Results received: No. Last updated: 2026-02-16.
Decision dates by country: DE: 2024-06-19, FR: 2024-07-12, ES: 2024-06-18, RO: 2024-06-26, IT: 2024-06-25, NL: 2024-06-20, PL: 2024-07-17, CZ: 2024-06-20

Condition(s): MET-driven, unresectable and locally advanced or metastatic Papillary Renal Cell Carcinoma
Product: DURVALUMAB, Savolitinib, MYCOPHENOLATE MOFETIL, Sutent 12.5 mg hard capsules, Sutent 25 mg hard capsules, Sutent 12.5 mg hard capsules, INFLIXIMAB, Sutent 25 mg hard capsules

Primary endpoint: PFS is defined as time from randomisation until disease progression per RECIST 1.1 as assessed by blinded independent central review (BICR), or death due to any cause.
Endpoint(s): a. and b. : 1. OS is defined as time from randomisation until the date of death due to any cause., a. and b. : 2. ORR is defined as the proportion of participants who have a complete response (CR) or partial response (PR) as determined by BICR per RECIST 1.1., a. and b. : 3. DoR will be defined as the time from the date of first documented response until date of documented progression per RECIST 1.1 as assessed by BICR or death due to any cause., a. and b. : 4. DCR at 24 or 48 weeks is defined as the percentage of participants who have a CR or PR or who have stable disease (SD) per RECIST 1.1 as assessed by BICR for at least 23 or 47 weeks, respectively after randomisation., a. and b. : 5. PFS2 will be defined as time from randomisation to the earliest of the progression event (following the initial progression), subsequent to the first subsequent therapy or death., a. and b. : 6. PFS is defined as time from randomisation until disease progression per RECIST 1.1 as assessed by blinded independent central review (BICR), or death due to any cause., c. Time to deterioration and change from baseline in symptoms, functioning, and HRQoL, d. The measures of interest are as follows: 1. participants randomised to savolitinib plus durvalumab: plasma concentration of savolitinib and its metabolites pre-dose (Ctrough) andpost-dose (C1h and C3h), serum concentration of durvalumab pre-dose (Ctrough) and at the end of infusion (Cmax), d.: 2. participants randomised to durvalumab monotherapy: serum concentration of durvalumab pre-dose (Ctrough) and at the end of infusion (Cmax)

Source: https://euclinicaltrials.eu/ctis-public/view/2022-503105-38-00